EU clinical trial 2023-509412-28-00: Safety and efficacy of once-weekly subcutaneous and once-daily oral NNC0487-0111 in participants with type 2 diabetes – a dose finding study
Protocol code: NN9490-7678
Sponsor: Novo Nordisk A/S (Pharmaceutical company). Phase: Therapeutic exploratory (Phase II). Countries: Romania (ended), Spain (ended), Poland (ended), Slovakia (ended), Hungary (ended), Croatia (ended), Germany (ended), Bulgaria (ended), Greece (ended).
Therapeutic area(s): Diseases [C] - Nutritional and Metabolic Diseases [C18]
Gender: Female, Male. Age: 18-64 years, 65+ years. Enrolment: 339.
Status: Ended. Start date (EU): 2024-07-26. End date (EU): 2025-10-08. End date: 2025-10-25. Decision date: 2024-07-11. Results received: No. Last updated: 2025-11-24.
Decision dates by country: PL: 2024-07-17, RO: 2024-07-22, HU: 2024-07-17, BG: 2024-07-22, SK: 2024-07-15, DE: 2024-07-12, ES: 2024-07-11, GR: 2024-07-22, HR: 2024-07-22

Condition(s): Type 2 Diabetes
Product: Placebo A, NNC0487-0111, NNC0487-0111, NNC0487-0111, Placebo C tablets, NNC0487-0111, METFORMIN, NNC0487-0111, NNC0487-0111, NNC0487-0111, DAPAGLIFLOZIN, NNC0487-0111

Primary endpoint: Change in HbA1c
Endpoint(s): Relative change in body weight, Change in body weight, Change in fasting plasma glucose (FPG), CGM: Change in time in range (TIR) 3.9–10.0 mmol/L (70–180 mg/dL), Change in body mass index (BMI), Change in waist circumference, Change in systolic blood pressure (SBP), Change in average 24 hour systolic blood pressure (SBP), Change in high sensitivity C-Reactive Protein (hsCRP), Change in total cholesterol, Change in high-density lipoprotein (HDL) cholesterol, Change in low-density lipoprotein (LDL) cholesterol, Change in triglycerides, Number of adverse events, Change in Urinary Albumin/Creatinine Ratio (UACR), Participant without macroalbuminuria (UACR < 300 mg/g) at baseline (week 0) developing (yes/no) new onset of macroalbuminuria (UACR ≥ 300 mg/g), Change in eGFR creatinine-cystatin C based CKD-EPI

Source: https://euclinicaltrials.eu/ctis-public/view/2023-509412-28-00